EU clinical trial 2023-505747-40-00: A Multicenter, Open-Label Phase IV Study to Evaluate Overall Health, Physical Activity, and Joint Outcomes, in Participants Aged ≥13 and < 70 Years with Severe or Moderate Hemophilia a Without FVIII Inhibitors on Emicizumab Prophylaxis
Protocol code: MO42623
Sponsor: F. Hoffmann-La Roche AG (Pharmaceutical company). Phase: Therapeutic use (Phase IV). Countries: Italy (ongoing, recruitment ended), Spain (ended), Hungary (ongoing, recruitment ended), Germany (ended).
Therapeutic area(s): Diseases [C] - Hemic and Lymphatic Diseases [C15]
Gender: Female, Male. Age: 0-17 years, 18-64 years, 65+ years. Enrolment: 45.
Start date (EU): 2022-04-20. Decision date: 2024-06-26. Results received: No. Last updated: 2025-10-31.
Decision dates by country: IT: 2024-07-08, HU: 2024-06-26, DE: 2024-06-28, ES: 2024-06-27

Condition(s): Severe or Moderate Hemophilia A
Product: Hemlibra 150 mg/mL solution for injection

Primary endpoint: 1. Joint status over time based on centrally reviewed Haemophilia Early Arthropathy Detection with Ultrasound (HEAD-US) scores with a specific focus on the synovitis score in participants with synovitis, 2. Clinical joint status over time based on the Hemophilia Joint Health Score (HJHS v2.1), excluding gait assessment, 3. Joint status at screening and month 36 based on centrally reviewed International Prophylaxis Study Group (IPSG) score (with MRI), 4. Number of problem joints and proportion of problem joints, defined as joints having chronic joint pain and/or limited range of movement due to compromised joint integrity (i.e., chronic synovitis and/or hemophilic arthropathy) with or without persistent bleeding, over time, 5. Number of target joint bleeds over time (target joints are defined as joints with ≥ 3 bleeds occurring in the same joint during the last 24 weeks), 6. HRQoL, as assessed through use of the Comprehensive Assessment Tool of Challenges in Hemophilia (CATCH) Questionnaire over time with a focus on the following domains: risk perception of recreational activities, restrictions experienced in recreational activities, preoccupation with disease, impact of treatment burden on HRQoL, and pain severity, 7. Change in the level of physical activity during the study as measured with a wearable activity tracker (Fitbit), 8. Change in daily step count, active minutes metabolic equivalents of tasks (METs), moderate to vigorous physical activity (MVPA; as per activity tracker default categorization), and type of physical activities, 9. Change in the time and intensity level of physical activity as measured by the International Physical Activity Questionnaire Short Format (IPAQ-SF), 10. Number of all bleeds (i.e., those treated and untreated with FVIII), treated bleeds, spontaneous bleeds, joint bleeds, treated joint bleeds, and target joint bleeds (i.e., bleed rate) over time (ABR) as assessed through use of the Bleed and Medication Questionnaire (BMQ), 11. Participant preference for emicizumab compared with previous FVIII regimen, as assessed through use of the Emicizumab Preference Survey (EmiPref) at month 6
Endpoint(s): 1. Incidence and severity of adverse events, with severity determined according to World Health Organization (WHO) toxicity scale, 2. Incidence of thromboembolic events, 3. Incidence of thrombotic microangiopathy, 4. Incidence of severe hypersensitivity, anaphylaxis, and anaphylactoid events, 5. Incidence and severity of injection-site reactions, 6. Prevalence of anti-drug antibodies (ADAs) against emicizumab at baseline and incidence of ADAs against emicizumab during the study, 7. Number and proportion of participants who develop anti-FVIII inhibitors (titer ≥ 0.6 BU/mL) at specified timepoints

Source: https://euclinicaltrials.eu/ctis-public/view/2023-505747-40-00